EU clinical trial 2024-519070-39-00: A phase II trial of an individualized treatment strategy for patients with metastatic non-clear cell renal carcinoma
Protocol code: UR1909
Sponsor: Region Hovedstaden (Hospital/Clinic/Other health care facility). Phase: Therapeutic exploratory (Phase II). Countries: Denmark (ended).
Therapeutic area(s): Diseases [C] - Neoplasms [C04]
Gender: Female, Male. Age: 18-64 years, 65+ years. Enrolment: 30.
Status: Ended. Start date (EU): 2020-03-06. End date (EU): 2026-03-18. Decision date: 2024-10-31. Results received: No. Last updated: 2026-02-28.

Condition(s): Metastatic non-clear cell renal cell carcinoma
Product: Tafinlar 75 mg hard capsules, Tarceva 150 mg film-coated tablets, KEYTRUDA 25 mg/mL concentrate for solution for infusion, CABOMETYX 60 mg film-coated tablets, Lynparza 100 mg film-coated tablets, OPDIVO 10 mg/mL concentrate for solution for infusion., XALKORI 250 mg hard capsules, Mekinist 2 mg film-coated tablets, Kadcyla 160 mg powder for concentrate for solution for infusion., Sutent 50 mg hard capsules, TAGRISSO 80 mg film-coated tablets, IBRANCE 125 mg hard capsules, YERVOY 5 mg/ml concentrate for solution for infusion, Alecensa 150 mg hard capsules, Imatinib Accord 400 mg film-coated tablets

Primary endpoint: Overall response rate (ORR) + Time-to-treatment failure (TTF)
Endpoint(s): Progression free survival. Overall survival. Disease control rate. Duration of response. Patient-reported-outcome (PRO) usability. Description of patient-reported-outcome (PRO). Number of hospital admissions. Description of hospital admissions. Description of adverse events.

Source: https://euclinicaltrials.eu/ctis-public/view/2024-519070-39-00